EU clinical trial 2024-520355-25-00: A Randomized, Double-Blind, Placebo-Controlled Phase 3 Trial of Descartes-08 in Patients With Generalized Myasthenia Gravis (MG)
Protocol code: RNAC-MG-002 (AURORA)
Sponsor: Cartesian Therapeutics Inc. (Pharmaceutical company). Phase: Therapeutic confirmatory (Phase III). Countries: Italy (ongoing, recruitment ended), Spain (ongoing, recruitment ended), Poland (ongoing, recruitment ended).
Therapeutic area(s): Diseases [C] - Nervous System Diseases [C10]
Gender: Female, Male. Age: 18-64 years, 65+ years. Enrolment: 29.
Status: Ongoing, recruitment ended. Start date (EU): 2025-10-10. Decision date: 2025-08-01. Results received: No. Last updated: 2026-05-08.
Decision dates by country: IT: 2025-08-06, PL: 2025-08-04, ES: 2025-08-01

Condition(s): generalized myasthenia gravis
Product: Placebo to Descartes-08, Descartes-08

Primary endpoint: Proportion of participants who have a decrease of ≥3 points in MG-ADL score at Month 4 compared to Baseline in the active versus placebo group.
Endpoint(s): Proportion of participants who have a decrease of ≥4 points in MGC score at Month 4 compared to Baseline in the active versus placebo group., Decrease from Baseline at Month 4 in MG-ADL score in active versus placebo groups., Decrease from Baseline at Month 4 in MGC score in active versus placebo groups., Proportion of participants who have a decrease of ≥4 points in QMG score at Month 4 compared to Baseline in the active versus placebo group., Decrease from baseline in MG-ADL score at Month 2 and Month 3 follow-up in the active versus placebo group., Decrease from baseline in MGC score at Month 2 and Month 3 follow-up in the active versus placebo group., Decrease from Baseline at Month 2, Month 3 and Month 4 in QMG score in active versus placebo groups.

Source: https://euclinicaltrials.eu/ctis-public/view/2024-520355-25-00